EU clinical trial 2023-504661-23-00: HYPATIA: A prospective randomised controlled trial of HYdroxychloroquine to improve Pregnancy outcome in women with AnTIphospholipid Antibodies
Sponsor: Rigshospitalet (Hospital/Clinic/Other health care facility). Phase: Therapeutic confirmatory (Phase III). Countries: Denmark (ongoing, recruiting), Ireland (authorised, recruitment pending), Italy (authorised, recruitment pending).
Therapeutic area(s): Diseases [C] - Female Urogenital Diseases and Pregnancy Complications [C13]; Diseases [C] - Immune System Diseases [C20]; Diseases [C] - Pathological Conditions, Signs and Symptoms [C23]
Gender: Female. Age: 18-64 years. Enrolment: 300.
Start date (EU): 2023-06-27. Decision date: 2023-05-16. Results received: No. Last updated: 2026-02-26.
Decision dates by country: DK: 2023-05-16, IE: 2025-07-11, IT: 2025-07-09

Condition(s): Antiphospholipid antibodies, APS
Product: Hydroxychloroquine sulfate 200 mg film-coated Tablets, The placebo is a white, circular, biconvex tablet debossed with "200" on one side and plain on the other side

Primary endpoint: The primary endpoint is a composite of three principal aPL-related adverse pregnancy outcomes: one or more pregnancy loss(es) (either < 10 weeks gestation or beyond 10 weeks of gestation of a morphologically normal fetus documented by ultrasound or by direct examination of the fetus) and premature birth of a morphologically normal neonate before 34 weeks due to any of: preeclampsia, eclampsia, recognized features of placental insufficiency
Endpoint(s): Pregnancy loss < 10 weeks gestation, Pregnancy loss > 10th week of gestation of a morphologically normal fetus documented by ultrasound or by direct examination of the fetus, Premature birth of a morphologically normal neonate < 34 weeks due to any of: pre-eclampsia, eclampsia, recognized features of placental insufficiency, Gestational age at delivery, Birth weight, Delivery by Caesarean section, Apgar score < 7 at 5 min, Neonatal morbidity (bleeding or thrombotic complications, infections, congenital abnormalities), Days to hospital discharge following delivery (mother & child), Thrombotic events in the mother during pregnancy and 6 weeks post-partum., Days of neonate in special care, Safety and tolerability of hydroxychloroquine in the mother and in the neonate

Source: https://euclinicaltrials.eu/ctis-public/view/2023-504661-23-00